EU clinical trial 2024-511559-17-00: Efficacy of peri-operative dexamethasone administration in single bundle anterior cruciate ligament reconstruction: a prospective randomized double-blinded placebo-controlled trial
Protocol code: DXAACL
Sponsor: Ospedale San Raffaele S.r.l. (Hospital/Clinic/Other health care facility). Phase: Therapeutic use (Phase IV). Countries: Italy (not authorised).
Therapeutic area(s): Diseases [C] - Musculoskeletal Diseases [C05]
Gender: Female, Male. Age: 18-64 years. Enrolment: 88.
Status: Not authorised. Decision date: 2024-12-17. Results received: No. Last updated: 2024-12-17.

Condition(s): Adult patients with indication of arthroscopic anterior cruciate ligament reconstruction
Product: SODIO CLORURO 0,9% BAXTER Soluzione per infusione, SOLDESAM 8 mg/2 ml soluzione iniettabile

Primary endpoint: Pain levels will be measured by VAS from participants in each treatment arm at rest and during walking
Endpoint(s): Pain levels with VAS from participants in each treatment arm at rest and during walking The number of episodes of nausea and vomiting will be recorded from participants in each treatment arm., Functional scores (range of movement, length of stay, and earlier return to activity of daily life evaluated in terms of walking with crutches in the days after surgery without invalidating pain) will be evaluated in patients in the control group versus study group. Number of patients who experience surgical site infection and complications (fever, wound infections, delayed tissue healing and gastrointestinal bleeding)

Source: https://euclinicaltrials.eu/ctis-public/view/2024-511559-17-00